EU clinical trial 2024-513353-73-00: Prospective, randomized, double-blind, placebo-controlled, crossover phase IIa study on the safety of EdoXaban in PortosinusOidal vaScUlar disorder (EXPOSURE)
Protocol code: EXPOSURE
Sponsor: Medical University Of Vienna (Educational Institution). Phase: Therapeutic exploratory (Phase II). Countries: Austria (ongoing, recruiting).
Therapeutic area(s): Diseases [C] - Digestive System Diseases [C06]
Gender: Female, Male. Age: 18-64 years, 65+ years. Enrolment: 56.
Status: Ongoing, recruiting. Start date (EU): 2025-04-04. Decision date: 2025-01-31. Results received: No. Last updated: 2025-01-31.

Condition(s): Porto-Sinusoidal Vascular Disorder
Product: Placebo consists of gelatine capsules filled with maltodextrin, Lixiana 60 mg film-coated tablets, Lixiana 30 mg film-coated tablets

Primary endpoint: Incidence of major bleedings (will be defined according to the International Society on Thrombosis and Haemostasis [ISTH])
Endpoint(s): To assess the preliminary efficacy of edoxaban treatment for the prevention of splanchnic vein thrombosis (SVT) development, To assess the effects of edoxaban treatment on spleen stiffness as a surrogate of portal hypertension severity measured before and after edoxaban treatment., To assess the preliminary efficacy of edoxaban treatment for the prevention of hepatic decompensation., To assess effects of edoxaban treatment on health-related quality of life.

Source: https://euclinicaltrials.eu/ctis-public/view/2024-513353-73-00